EU clinical trial 2023-505248-20-00: HYPER-trial Hyperemic mYocardial Perfusion by adEnosine at diffeRent doses
Sponsor: Region Skane (Hospital/Clinic/Other health care facility). Phase: Therapeutic use (Phase IV). Countries: Sweden (ongoing, recruiting).
Therapeutic area(s): Diseases [C] - Cardiovascular Diseases [C14]; Analytical, Diagnostic and Therapeutic Techniques and Equipment [E] - Diagnosis [E01]
Gender: Female, Male. Age: 18-64 years, 65+ years. Enrolment: 180.
Status: Ongoing, recruiting. Start date (EU): 2024-10-14. Decision date: 2024-03-05. Results received: No. Last updated: 2024-03-05.

Condition(s): Chronic coronary syndrome
Product: Clariscan 0,5 mmol/ ml injektionsvätska, lösning, Adenosin Life Medical 5 mg/ml, Injektions-/infusionsvätska, lösning.

Primary endpoint: The primary endpoint, myocardial hyperemia, is assessed by quantitative myocardial perfusion CMR imaging (ml/min/g).

Source: https://euclinicaltrials.eu/ctis-public/view/2023-505248-20-00